EU clinical trial 2023-508507-20-00: A Phase 3, multicenter, double-blind, randomized, placebo-controlled study of ivosidenib in participants ≥18 years of age with locally advanced or metastatic conventional chondrosarcoma with an IDH1 mutation, untreated or previously treated with 1 or 2 systemic treatment regimens (CHONQUER study)
Protocol code: CL3-95031-007
Sponsor: Institut De Recherches Internationales Servier IRIS (Pharmaceutical company). Phase: Therapeutic confirmatory (Phase III). Countries: Germany (ongoing, recruiting), Italy (ongoing, recruiting), France (ongoing, recruiting), Spain (ongoing, recruiting), Netherlands (authorised, recruiting), Belgium (ongoing, recruiting), Denmark (ongoing, recruiting).
Therapeutic area(s): Diseases [C] - Neoplasms [C04]
Gender: Female, Male. Age: 18-64 years, 65+ years. Enrolment: 50.
Start date (EU): 2025-04-03. Decision date: 2024-06-10. Results received: No. Last updated: 2026-07-08.
Decision dates by country: DK: 2025-08-12, DE: 2024-06-12, FR: 2024-06-17, ES: 2024-06-10, IT: 2024-06-11, NL: 2024-06-17, BE: 2025-07-24

Condition(s): Locally advanced or metastatic conventional chondrosarcoma with an IDH1 mutation, untreated or previously treated with 1 or 2 systemic treatment regimens
Product: AG-120/S95031 250mg film-coated tablet, Ivosidenib-matched Placebo Tablets

Primary endpoint: Progression-free survival (PFS) based on Blinded Independent Central Reviewer (BICR) assessment in Grade 1 and Grade 2 participants
Endpoint(s): PFS based on BICR assessment in all randomized participants, Overall survival (OS) in Grade 1 and Grade 2 participants, OS in all randomized participants, PFS based on Investigator assessment in Grade 1 and Grade 2 participants and in all randomised participants, Objective response (OR) (complete response(CR) or partial response (PR)) of anti-tumor activity (using Response Evaluation Criteria in Solid Tumors (RECIST) v1.1) in Grade 1 and Grade 2 participants and in all randomised participants, Duration of response (DOR) in Grade 1 and Grade 2 participants and in all randomised participants, Time to response (TTR) in Grade 1 and Grade 2 participants and in all randomised participants, Disease control (DC) CR, PR, or stable disease (SD)) in Grade 1 and Grade 2 participants and in all randomised participants, Duration of disease control (DoDC) in Grade 1 and Grade 2 participants and in all randomised participants, Number of Adverse Events (AEs), Number of Serious Adverse Events (SAEs), Number of Adverse Events of Special Interest (AESIs), Number of Adverse Events (AEs) leading to discontinuation, treatment interruption, and dose reduction, European Organization for the Research and Treatment of Cancer Quality of Life Questionnaire (EORTC QLQ-C30) score, European Quality of Life 5 Dimensions 5 Level (EQ-5D-5L) score, Patient-Reported Outcomes Measurement Information System (PROMIS) score, Ivosidenib and 2-hydroxyglutarate (2-HG) concentration in plasma

Source: https://euclinicaltrials.eu/ctis-public/view/2023-508507-20-00